EU clinical trial 2023-508024-36-00: Effects of Levosimendan in patients being weaned from venoarterial extracorporal membrane oxygenation. A randomized controlled investigator driven phase II trial
Sponsor: Allgemeines Krankenhaus Der Stadt Wien Universitatskliniken, Medical University Of Vienna (Hospital/Clinic/Other health care facility, Educational Institution). Phase: Therapeutic exploratory (Phase II). Countries: Austria (ongoing, recruiting).
Therapeutic area(s): Diseases [C] - Cardiovascular Diseases [C14]
Gender: Female, Male. Age: 18-64 years, 65+ years. Enrolment: 46.
Status: Ongoing, recruiting. Start date (EU): 2024-07-05. Decision date: 2024-03-11. Results received: No. Last updated: 2024-03-11.

Condition(s): Cardiogenic Shock
Product: Cernevit, Pulver zur Herstellung einer Injektions- oder einer Infusionslösung, Levosimendan EQL Pharma 2,5mg/ml Konzentrat zur Herstellung einer Infusionslösung

Primary endpoint: • Change in left ventricular outflow tract velocity time integral measured by Doppler echocardiography from baseline to 72h after initiation ECMO or before cessation of ECMO support, whichever occurs first
Endpoint(s): Change in pulse pressure from baseline to 72h after initiation of ECMO or before cessation of ECMO support, whichever occurs first; ECMO weaning failure, defined as death during ECMO support, death within 24 h after ECMO removal or need for reimplantation of ECMO within 24 h. All cause mortality at 28 days, Urinary output for the first 48 hours post cessation of ECMO support, Central venous saturation at 4, 8, 12, 24 and 48 hours post cessation of ECMO support, Total days requiring ECMO

Source: https://euclinicaltrials.eu/ctis-public/view/2023-508024-36-00